EU clinical trial 2025-522444-40-00: An open-label, single-arm extension study to evaluate the long-term safety, tolerability, and efficacy of leniolisib for immune dysregulation in patients with primary immunodeficiency
Protocol code: LE 7X01
Sponsor: Pharming Technologies B.V. (Pharmaceutical company). Phase: Therapeutic exploratory (Phase II). Countries: Spain (ongoing, recruiting).
Therapeutic area(s): Diseases [C] - Immune System Diseases [C20]
Gender: Female, Male. Age: 0-17 years, 18-64 years, 65+ years. Enrolment: 6.
Status: Ongoing, recruiting. Start date (EU): 2026-02-10. Decision date: 2026-01-23. Results received: No. Last updated: 2026-07-24.

Condition(s): primary immunodeficiency
Product: CDZ173/Leniolisib, CDZ173/Leniolisib, CDZ173/Leniolisib, CDZ173/Leniolisib

Primary endpoint: AEs (via assessment of vital signs, safety labs, physical exams, and overall trial safety monitoring)
Endpoint(s): Hemoglobin over time, Platelet count over time, ANC over time, CT evidence of granulomatous lymphocytic ILD or other PID-related ILD evaluated using Hartmann scoring methodology over time, Results of pulmonary function testing over time, including FEV1, FVC, TLC, RV, DLCO, Measurements of lymphoproliferation over time measured as the SPD in the index lesions selected at baseline of the preceding study per the Cheson methodology, Measurements of lymphoproliferation over time measured as the SPD in the non-index lesions selected at baseline of the preceding study per the Cheson methodology, Spleen size over time measured by 3D volume and 2D size of spleen, CD4+ T cell count over time, CD8+ T cell count over time, B cell count over time, Percentages of naïve B cells and CD21low B cells over time, Levels of CXCL13 over time, Levels of soluble IL-2Rα over time

Source: https://euclinicaltrials.eu/ctis-public/view/2025-522444-40-00